EU clinical trial 2026-525475-96-00: The effect of beta-blockers on how you feel and recover after a heart attack when your heart is still pumping well
Protocol code: S71709
Sponsor: UZ Leuven (Hospital/Clinic/Other health care facility). Phase: Therapeutic use (Phase IV). Countries: Belgium (authorised, recruiting).
Therapeutic area(s): Diseases [C] - Cardiovascular Diseases [C14]
Gender: Female, Male. Age: 18-64 years, 65+ years. Enrolment: 160.
Status: Authorised, recruiting. Start date (EU): 2026-06-10. Decision date: 2026-05-18. Results received: No. Last updated: 2026-05-18.

Condition(s): Myocardial infarction with preserved ejection fraction
Product: BISOPROLOL, BISOPROLOL, BISOPROLOL, BISOPROLOL

Primary endpoint: The trial will assess group differences in the Mental Component Summary (MCS) and Physical Component Summary (PCS) domains of the SF-36 scale between patients taking beta blockers and those not taking beta blockers after 3 months of cardiac rehabilitation.
Endpoint(s): Group differences in all individual SF-36 domains, including physical functioning, role physical, bodily pain, general health, vitality, role emotional and mental health between patients taking beta blockers and those not taking beta blockers after 3 months of cardiac rehabilitation.., Group differences in absolute and relative changes in VO2 peak (mL/kg/min) from start to 3 months of cardiac rehabilitation, Group differences in absolute and relative changes in VO2 at VT1 (mL/kg/min) from start to 3 months of cardiac rehabilitation, Group differences in absolute and relative changes in peak load (Watt) from start to 3 months of cardiac rehabilitation, Group differences in absolute and relative changes in time to exhaustion during a constant-load exercise test performed at VT1 (determined at the baseline CPET) from start to 3 months of cardiac rehabilitation, Group differences in absolute and relative changes in % heart rate reserve from baseline to 3 months of cardiac rehabilitation, Group differences in absolute and relative changes in one-repetition maximum test (leg press) from start to 3 months cardiac rehabilitation, Group differences in time to exhaustion (in seconds) during a constant-load exercise test performed at VT1 (determined at the baseline CPET) at start and after 3 months of cardiac rehabilitation, Group differences in % heart rate reserve (HRpeak-HRrest)/(APMHR calculated by the Tanaka equation14 - HRrest) at start and after 3 months of cardiac rehabilitation, Group differences in reason for CPET termination at baseline and after 3 months of cardiac rehabilitation based on CPET data, Group differences in absolute and relative changes in MCS and PCS from hospital discharge to the start of cardiac rehabilitation, Group differences in absolute and relative changes in MCS and PCS from the start of CR to 3 months of cardiac rehabilitation, Group differences in absolute and relative changes in MCS and PCS from the start of cardiac rehabilitation to 1 year of cardiac rehabilitation, Group differences in DASS-21 scale domains for depression, anxiety and stress at 1 month of cardiac rehabilitation, Group differences in International Index of Erectile Function (IIEF scale) for male participants at 2 months of cardiac rehabilitation, Group differences in •Female Sexual Function Index (FSFI scale) for female participants at 2 months of cardiac rehabilitation, Within-patient changes in PCS and MCS from the start of CR to one year after cardiac rehabilitation, Group differences in all-cause and cardiovascular mortality after 3 months of CR

Source: https://euclinicaltrials.eu/ctis-public/view/2026-525475-96-00